EU clinical trial 2024-520201-39-00: A Phase 2a, Two-Part, Open-Label and Randomized Study to Evaluate the Safety and Efficacy of OD-07656 and of Subsequent Vedolizumab Therapy in Patients with Moderately to Severely Active Ulcerative Colitis
Protocol code: OD-07656-201
Sponsor: Odyssey Therapeutics Inc. (Pharmaceutical company). Phase: Therapeutic exploratory (Phase II). Countries: Poland (ongoing, recruitment ended), Croatia (ended), Lithuania (ended), Czechia (ended), Hungary (not authorised), Belgium (ended), Austria (ended).
Therapeutic area(s): Diseases [C] - Digestive System Diseases [C06]
Gender: Female, Male. Age: 18-64 years, 65+ years. Enrolment: 70.
Start date (EU): 2025-08-28. Decision date: 2025-06-25. Results received: No. Last updated: 2026-07-31.
Decision dates by country: BE: 2025-06-25, HR: 2025-06-30, HU: 2025-06-30, LT: 2025-06-26, AT: 2025-06-30, CZ: 2025-06-26, PL: 2025-06-30

Condition(s): Moderately to Severely Active Ulcerative Colitis
Product: Entyvio 300 mg powder for concentrate for solution for infusion, OD-07656, OD-07656

Primary endpoint: Incidence of treatment-emergent adverse events (TEAEs), serious TEAEs, TEAEs of special interest and treatment discontinuations due to TEAEs, Changes in clinical laboratory parameters, electrocardiogram parameters, and vital signs, Change from baseline in 3-component modified Mayo Clinic Score (MMCS) (defined as sum of stool frequency subscore [SFS], rectal bleeding subscore [RBS], and Mayo endoscopic subscores [MES]a) at Week X
Endpoint(s): Proportion of participants who achieve clinical remission defined as 3‑component MMCS ≤2 (SFS ≤1, RBS = 0, and MES ≤1) at Week X, Proportion of participants who have a clinical response per 3 component MMCS (defined as a decrease from baseline of ≥2 points and ≥30%, and either a decrease in RBS of ≥1 point or an absolute RBS of 0 or 1) at Week X, Proportion of participants who achieve clinical remission per MMCS at Week X

Source: https://euclinicaltrials.eu/ctis-public/view/2024-520201-39-00